EU clinical trial 2023-507883-38-00: I4V-MC-JAHU: Open-Label, Randomized Study with a Tocilizumab Reference Arm to Evaluate Safety, Efficacy and Pharmacokinetics of Baricitinib in Children from 1 to Less Than 18 Years of Age with Systemic Juvenile Idiopathic Arthritis
Protocol code: I4V-MC-JAHU
Sponsor: Eli Lilly & Co. (Pharmaceutical company). Phase: Therapeutic confirmatory (Phase III). Countries: Belgium (ended), Poland (ended), Czechia (ended), France (ended), Austria (ended), Italy (ended), Spain (ended).
Therapeutic area(s): Diseases [C] - Immune System Diseases [C20]
Gender: Female, Male. Age: 0-17 years. Enrolment: 30.
Status: Ended. Start date (EU): 2019-11-18. End date (EU): 2026-06-05. Decision date: 2024-02-20. Results received: No. Last updated: 2026-05-27.
Decision dates by country: BE: 2024-02-23, ES: 2024-02-20, CZ: 2024-02-22, AT: 2024-03-26, IT: 2024-04-03, FR: 2024-03-12, PL: 2024-03-20

Condition(s): Systemic Juvenile Idiopathic Arthritis
Product: JAK1/JAK2 inhibitor, Tocilizumab, Placebo to match 4 mg tablet, Placebo to match 1 mg tablet, Placebo to match 2 mg/mL oral suspension, BARICITINIB, TOCILIZUMAB, Placebo to match 2 mg tablet, BARICITINIB, Baricitinib

Primary endpoint: Percentage of Participants Achieving Adapted Pediatric American College of Rheumatology 30 (PediACR30) Response Criteria at Week 12

Source: https://euclinicaltrials.eu/ctis-public/view/2023-507883-38-00